EU clinical trial 2023-505908-28-00: A RANDOMIZED PHASE I, DOUBLE-BLIND, PARALLEL, COMPARATIVE ASSESSMENT OF PHARMACOKINETICS, SAFETY, PHARMACODYNAMICS, AND IMMUNOGENICITY OF LT-01 (AN OMALIZUMAB BIOSIMILAR CANDIDATE [TEST]) LYOPHYLIZED POWDER FOR SUBCUTANEOUS INJECTION VERSUS EU-APPROVED XOLAIR® LYOPHYLIZED POWDER FOR SUBCUTANEOUS INJECTION (REFERENCE) IN HEALTHY SUBJETCS: CIMA STUDY.
Protocol code: LT-02-19
Sponsor: Laboratorios Liomont S.A. de C.V. (Pharmaceutical company). Phase: Human Pharmacology (Phase I)- Bioequivalence Study. Countries: Spain (ended).
Therapeutic area(s): Diseases [C] - Immune System Diseases [C20]
Gender: Female, Male. Age: 18-64 years. Enrolment: 68.
Status: Ended. Start date (EU): 2025-02-26. End date (EU): 2025-11-13. End date: 2026-01-05. Decision date: 2025-01-15. Results received: No. Last updated: 2025-05-17.

Condition(s): Chronic spontaneous urticaria, Allergic asthma, Chronic rhinosinusitis with nasal polyps

Source: https://euclinicaltrials.eu/ctis-public/view/2023-505908-28-00